EU clinical trial 2025-522390-11-00: A phase 2a open-label study to assess the safety, tolerability, and dosing regimen of antithrombotic heparin proteoglycan mimetic APAC (antiplatelet, anticoagulant) in patients with peripheral arterial occlusive disease and chronic limb-threatening ischemia undergoing endovascular revascularization (HEALING -study)
Protocol code: APLA-PAOD-CS02
Sponsor: Aplagon Oy (Pharmaceutical company). Phase: Therapeutic exploratory (Phase II). Countries: Finland (ongoing, recruiting).
Therapeutic area(s): Diseases [C] - Cardiovascular Diseases [C14]
Gender: Female, Male. Age: 18-64 years, 65+ years. Enrolment: 42.
Status: Ongoing, recruiting. Start date (EU): 2026-01-29. Decision date: 2025-09-15. Results received: No. Last updated: 2026-07-22.

Condition(s): Peripheral arterial occlusive disease (PAOD), Chronic limb-threatening ischemia (CLTI)
Product: APAC, Heparin LEO 5000 IU/ml injektioneste, liuos, SODIUM CHLORIDE

Primary endpoint: Part A: Occurrence and severity of treatment-emergent adverse events (TEAEs) from baseline to D29 (Part A1) and D90 (Part A2) after the first dose of APAC. Other safety and tolerability endpoints: • physical examination findings • vital signs • clinical laboratory data • bleeding events (International Society on Thrombosis and Haemostasis (ISTH) bleeding criteria, Part B: Occurrence and severity of TEAEs from baseline to D90 after the first dose of APAC Other safety and tolerability endpoints: • physical examination findings • vital signs • clinical laboratory data • bleeding events (ISTH bleeding criteria) • surgical AEs, collected according to the Clavien-Dindo classification
Endpoint(s): Part A: 1. Changes in the clinical status of PAOD a. Fontaine classification, b. Wound Ischemia foot Infection (WIfI) scoring, c. hemodynamics (toe-brachial blood pressure index [TBI] and ankle-brachial systolic blood pressure index [ABI]) at rest and in Part A2 patients also after treadmill exercise test, and d. in Part A2, maximal walking distance in a treadmill exercise test (3.2 km/h, 10% incline)., Part A: 2. Changes in PD and PK of selected biomarkers, Part A: 3. MALE and MACE-free survival and Quality of life (assessed using quality of life questionnaire EQ-5D-5L, ischemic pain using visual analog scale, and ischemic ulcers or gangrene and physical performance using tailored questionnaire)., Part B: 1. Changes in the clinical status of PAOD a. Fontaine classification, b. WIfI scoring, c. outcome of recanalization (hemodynamics; TBI and ABI) at rest., Part B: 2. Changes in PD and PK of selected biomarkers, Part B: 3. MALE and MACE-free survival and Quality of life (assessed using quality of life questionnaire EQ-5D-5L, ischemic pain using visual analog scale, ischemic ulcers or gangrene, and physical performance using tailored questionnaire).

Source: https://euclinicaltrials.eu/ctis-public/view/2025-522390-11-00